EU clinical trial 2024-515830-34-00: A multicentre, prospective, open-label, uncontrolled Phase 3 study to assess the efficacy, safety and pharmacokinetics of Atenativ in patients with congenital antithrombin deficiency undergoing surgery or delivery
Protocol code: ATN-106
Sponsor: Octapharma AG (Pharmaceutical company). Phase: Therapeutic confirmatory (Phase III). Countries: France (authorised, recruitment pending), Italy (ongoing, recruiting), Austria (ongoing, recruiting), Hungary (ongoing, recruiting), Germany (ongoing, recruiting), Spain (ongoing, recruiting), Czechia (authorised, recruitment pending), Romania (authorised, recruitment pending).
Therapeutic area(s): Diseases [C] - Congenital, Hereditary, and Neonatal Diseases and Abnormalities [C16]
Gender: Female, Male. Age: 18-64 years, 65+ years. Enrolment: 28.
Start date (EU): 2023-02-14. Decision date: 2024-10-10. Results received: No. Last updated: 2026-07-20.
Decision dates by country: RO: 2025-08-11, CZ: 2025-05-15, IT: 2024-10-14, ES: 2025-01-21, DE: 2025-01-24, AT: 2024-10-14, FR: 2024-10-11, HU: 2024-10-11

Condition(s): Congenital antithrombin deficiency
Product: Atenativ 1000 I.E. Pulver und Lösungsmittel zur Herstellung einer Infusionslösung, Atenativ 1000 I.E. - Pulver und Lösungsmittel zur Herstellung einer Injektions- oder Infusionslösung, ATENATIV 1000 U.I., polvo y disolvente para solución para perfusión, ATENATIV 50 UI/mL, poudre et solvant pour solution pour perfusion, Atenativ 1000 UI/20 ml polvere e solvente per soluzione per infusione endovenosa, Atenativ 50 NE/ml por és oldószer oldatos infúzióhoz vagy injekcióhoz

Primary endpoint: Incidence of the composite of TEs and TEEs in patients with congenital antithrombin deficiency under cover of Atenativ for surgical procedures or parturition to 30 days post treatment initiation.
Endpoint(s): • PK parameters: o Area under the curve (AUCnorm(0–∞)) o Maximum plasma concentration (Cmax) o Half-life (t1/2) o Mean residence time (MRT) o Clearance (CL) o Incremental in vivo recovery (IVR; peak concentration of antithrombin observed within the first hour after infusion) o Volume of distribution at steady state (Vss) o Time to reach Maximum Plasma Concentration (Tmax), • Efficacy Parameters: o Antithrombin activity; o Coagulation parameters (activated partial thromboplastin time [aPTT], prothrombin time [PT], international normalised ratio [INR] and fibrinogen), • Safety Parameters: o Adverse events (AEs) and serious AEs (SAEs); o Length of hospital stay; o Vital signs (including systolic and diastolic blood pressure, pulse rate, body temperature, respiration rate, results of physical examination); o Standard haematological and clinical chemistry safety variables, as well as thrombogenicity markers including D-dimer, prothrombin fragment 1 + 2 (F1+2)*, and thrombin-antithrombin complex (TAT)* * if available from local laboratories

Source: https://euclinicaltrials.eu/ctis-public/view/2024-515830-34-00